EU clinical trial 2023-510341-19-00: A phase III study to assess efficacy and safety of N-Acetyl-GED-0507-34-LEVO gel 5%, applied once daily for 12 weeks in patients with acne vulgaris (GEDACNE-2)
Protocol code: NACGED0507ACN0123B
Sponsor: PPM Services S.A. (Pharmaceutical company). Phase: Therapeutic confirmatory (Phase III). Countries: Italy (ended), Spain (ended), Poland (ended).
Therapeutic area(s): Diseases [C] - Skin and Connective Tissue Diseases [C17]
Gender: Female, Male. Age: 0-17 years, 18-64 years. Enrolment: 310.
Status: Ended. Start date (EU): 2024-11-14. End date (EU): 2026-05-21. End date: 2026-05-29. Decision date: 2024-09-30. Results received: No. Last updated: 2025-11-10.
Decision dates by country: IT: 2024-09-30, ES: 2024-10-03, PL: 2024-10-07

Condition(s): acne vulgaris
Product: N-acetyl-ged-0507-34-levo corresponding vehicle, N-Acetyl-GED-0507-34-Levo GEL 5%

Primary endpoint: The following family of Efficacy Endpoint E1 and E2 will be evaluated: a. Endpoint 1 (E1): the relative change from baseline in total lesion count (inflammatory plus non-inflammatory) at V5/Wk12 on the face, The following family of Efficacy Endpoint E1 and E2 will be evaluated: b. Efficacy Endpoint 2 (E2): proportion of patients with an IGA success at V5/Wk12. IGA success is defined according to the patient’s age as: • a score of “clear” (score = 0) or “almost clear” (score = 1) for patients aged ≥ 9 and ≤ 14 years • a score of “clear” (score = 0) or “almost clear” (score = 1) and at least a 2-score point reduction in IGA at V5/Wk12 for patients aged > 14 and < 50 years
Endpoint(s): Efficacy endpoint - FACE: Absolute change from baseline in total lesion count at V5/Wk12, Efficacy endpoint - FACE: Percentage of patients who achieve an IGA success over the study duration (i.e., score of 1 [almost clear] or 0 [clear] for patients aged ≥ 9 and ≤ 14 years; score of 1 [almost clear] or 0 [clear] and at least a two-grade improvement from baseline for patients aged > 14 and < 50 years), Efficacy endpoint - FACE: Change from baseline in total lesion count over the study duration, Efficacy endpoint - FACE: Change from baseline in inflammatory lesion count over the study duration, Efficacy endpoint - FACE: Change from baseline in non-inflammatory lesion count over the study duration., Efficacy endpoint - TRUNK: Absolute change from baseline in total lesion count at V5/Wk12, Efficacy endpoint - TRUNK: Percentage of patients who achieve a PGA score of 1 (almost clear) or 0 (clear) and at least a two-grade improvement from baseline over the study duration, Efficacy endpoint - TRUNK: Change from baseline in truncal total lesion total count over the study duration, Efficacy endpoint - TRUNK: Change from baseline in truncal inflammatory lesion count over the study duration, Efficacy endpoint - TRUNK: Change from baseline in truncal non-inflammatory lesion count over the study duration., Efficacy endpoint - OTHER: Dermatology Life Quality Index (DLQI) / Children’s Dermatology Life Quality Index (C-DLQI (C-DLQI for patients from 9 to 16 years old), completed by the patient at the Baseline and Week 12/EoT visits (prior to any Investigator assessments to not impact the patient’s answers to the quality of life questionnaire), Efficacy endpoint - OTHER: Additional assessment at the Baseline and Week 12/EoT visits., Efficacy endpoint - OTHER: Additional Monitoring (not mandatory, following specific consent) at the Baseline and Week 12/EoT visits., Safety and tolerability endpoint: Incidence of all Adverse Events (AEs), Treatment-Emergent Adverse Events (TEAES), Adverse Drug Reactions (ADRs), Serious Adverse Events (SAEs) throughout the study with special attention to local TEAEs concerning the treated facial area (local dermal safety), and systemic TEAEs, Safety and tolerability endpoint: Frequency of discontinuation of treatment due to TEAEs, Safety and tolerability endpoint: Changes from baseline of vital signs during the study, Safety and tolerability endpoint: Physical examination during the study, Safety and tolerability endpoint: Change from baseline of local tolerability- Application site signs/symptoms during the study* *Local tolerability will be evaluated on the basis of the following signs and symptoms: application site non-lesional erythema, application site exfoliation, and application site dryness, stinging, burning, itching. For each sign/symptom, a severity score will be assigned using a 4-point scale from 0 = absent to 3 = severe., Safety and tolerability endpoint: Assessment of overall application site irritation at V5/Wk12.

Source: https://euclinicaltrials.eu/ctis-public/view/2023-510341-19-00